EU clinical trial 2025-524823-34-00: Doxycycline post-exposure prophylaxis: Weekly versus event-driven Intake for STI prevention among MSM and TGW taking PrEP (Doxy-WISE study)
Protocol code: Doxy-WISE
Sponsor: Institute Of Tropical Medicine (Hospital/Clinic/Other health care facility). Phase: Therapeutic confirmatory (Phase III). Countries: Belgium (ongoing, recruiting).
Therapeutic area(s): Diseases [C] - Bacterial Infections and Mycoses [C01]
Gender: Male. Age: 18-64 years, 65+ years. Enrolment: 556.
Status: Ongoing, recruiting. Start date (EU): 2026-06-17. Decision date: 2026-03-06. Results received: No. Last updated: 2026-03-10.

Condition(s): Sexually Transmitted Infections
Product: Doxycycline Sandoz 100 mg tabletten, Doxycycline EG 200 mg Tabletten

Primary endpoint: Incidence rate ratio of NG, CT, and TP infections in the W-DoxyPEP vs ED-DoxyPEP arms
Endpoint(s): Rate ratio of tetracyclines, macrolides, cephalosporins, and penicillins in the W-DoxyPEP vs ED-DoxyPEP arms, MIC distribution (doxycycline/cefixime/ciprofloxacin) of commensal Neisseria spp., oral streptococci and E. coli in the W-DoxyPEP vs ED-DoxyPEP arms, Incidence rate ratio of symptomatic NG infections in the W-DoxyPEP vs ED-DoxyPEP arms, Incidence rate ratio of symptomatic CT infections in the W-DoxyPEP vs ED-DoxyPEP arms, Incidence rate ratio of symptomatic TP infections in the W-DoxyPEP vs ED-DoxyPEP arms, Incidence rate ratio of all NG infections in the W-DoxyPEP vs ED-DoxyPEP arms, Incidence rate ratio of all CT infections in the W-DoxyPEP vs ED-DoxyPEP arms, Incidence rate ratio of all TP infections in the W-DoxyPEP vs ED-DoxyPEP arms, Tetracycline MIC distribution of NG isolates in the W-DoxyPEP vs ED-DoxyPEP arms, participants' perception/experience, preference, and acceptability in using doxyPEP, Cost of integrating W-DoxyPEP vs ED-DoxyPEP in routine HIV-PrEP follow-up, if the strategy is proved to be effective, incremental cost per STI avoided/Quality of life Adjusted Life Years (QALY) gained

Source: https://euclinicaltrials.eu/ctis-public/view/2025-524823-34-00